EU clinical trial 2023-507179-23-00: LIGHTBEAM-U01-Substudy 01B: A Phase 1/2 Substudy to Evaluate the Safety and Efficacy of Pembrolizumab in Combination with Investigational Agents in Pediatric and Young Adult Participants with Hematologic Malignancies or Solid Tumors.
Protocol code: MK-9999-01B
Sponsor: Merck Sharp & Dohme LLC (Pharmaceutical company). Phase: Phase I and Phase II (Integrated)- Other. Countries: Denmark (not authorised).
Therapeutic area(s): Diseases [C] - Neoplasms [C04]
Gender: Female, Male. Age: 0-17 years. Enrolment: 2.
Status: Not authorised. Decision date: 2024-04-15. Results received: No. Last updated: 2024-04-15.

Condition(s): Hematologic Malignancies or Solid Tumors in Pediatric and Young Adults
Product: KEYTRUDA 25 mg/mL concentrate for solution for infusion

Primary endpoint: Part 1: Area Under the Curve (AUC), Part 1: Maximum Concentration (Cmax), Part 1: Concentration in the Blood Immediately Before the Next Dose (Ctrough), Part 1: Number of Participants Who Experience Dose-limiting Toxicities (DLTs), Parts 1 and 2: Number of Participants Who Report at Least 1 Adverse Event (AE), Parts 1 and 2 : Number of Participants Who Discontinue Study Drug Due to an AE, Parts 1 and 2: Objective Response Rate (ORR) per Lugano Response Criteria by Blinded Independent Central Review (BICR), Parts 1 and 2: ORR per Response Evaluation Criteria in Solid Tumors Version 1.1 (RECIST 1.1) by Investigator
Endpoint(s): Parts 1 and 2: ORR per Lugano Response Criteria by Investigator, Parts 1 and 2: Disease Control Rate (DCR) per Lugano Response Criteria by BICR, Parts 1 and 2: DCR per RECIST 1.1 by Investigator, Parts 1 and 2: Duration of response (DOR) per Lugano Response Criteria by BICR, Parts 1 and 2: DOR per RECIST 1.1 by Investigator, Parts 1 and 2: Progression Free Survival (PFS) per Lugano Response Criteria by BICR, Parts 1 and 2: PFS per RECIST 1.1 by Investigator, Parts 1 and 2: Overall Survival (OS), Part 2: Area Under the Curve (AUC), Part 2: Maximum Concentration (Cmax), Part 2: Concentration in the Blood Immediately Before the Next Dose (Ctrough), Parts 1 and 2: Antidrug Antibody (ADA) Levels, Parts and 2: Biomarkers for Classical Hodgkin Lymphoma (cHL)

Source: https://euclinicaltrials.eu/ctis-public/view/2023-507179-23-00